EU clinical trial 2023-503332-40-00: A study in healthy people to test how well repeated doses of BI 3032950 are tolerated
Protocol code: 1486-0002
Sponsor: Boehringer Ingelheim International GmbH (Industry). Phase: Human Pharmacology (Phase I)- Other. Countries: Belgium (ended).
Therapeutic area(s): Phenomena and Processes [G] - Physiological processes [G07]
Gender: Male. Age: 18-64 years, 65+ years. Enrolment: 40.
Status: Ended. Start date (EU): 2023-09-05. End date (EU): 2024-08-19. Decision date: 2023-08-01. Results received: No. Last updated: 2024-07-08.
Decision dates by country: BE: 2023-08-18

Condition(s): Healthy

Source: https://euclinicaltrials.eu/ctis-public/view/2023-503332-40-00